EU clinical trial 2023-508442-18-00: Efficacy and safety of different antimicrobial DURATions for the treatment of Infections associated with Osteosynthesis Material implanted after long bone fractures (DURATIOM). Phase 3 pragmatic multicenter open labelled randomized trial.
Protocol code: DURATIOM
Sponsor: Fundacion Publica Andaluza Para La Gestion De La Investigacion En Salud De Sevilla (Laboratory/Research/Testing facility). Phase: Therapeutic confirmatory (Phase III). Countries: Spain (ongoing, recruiting).
Therapeutic area(s): Diseases [C] - Bacterial Infections and Mycoses [C01]
Gender: Female, Male. Age: 0-17 years, 18-64 years, 65+ years. Enrolment: 364.
Status: Ongoing, recruiting. Start date (EU): 2024-04-14. Decision date: 2024-04-10. Results received: No. Last updated: 2026-07-21.

Condition(s): Patients with an infection of the osteosynthesis material implanted after a long bone fracture, who are treated by surgical debridement with retention of the implant plus targeted antimicrobial therapy or by surgical debridement with removal of the material. These patients have the osteosynthesis material implanted to stabilize and help heal the fracture and who meet the criteria for Infections associated with the osteosynthesis material. -arm without/with removal MO: 256/108pac (364pac)
Product: AMOXICILLIN SODIUM, DAPTOMYCIN, CLOXACILLIN, CLINDAMYCIN, LINEZOLID, VANCOMYCIN, DAPTOMYCIN, AMOXICILLIN SODIUM, AMPICILLIN, MEROPENEM, CIPROFLOXACIN, CEFTRIAXONE, RIFAMPICIN, CLINDAMYCIN, CEFTRIAXONE, CLOXACILLIN, TEICOPLANIN, CEFEPIME, Septrin Forte 160 mg/800 mg Tablets, MEROPENEM, CEFTAZIDIME, CIPROFLOXACIN, AMOXICILLIN, VANCOMYCIN, AMOXICILLIN SODIUM, RIFAMPICIN, CEFEPIME, AMOXICILLIN, CEFTAZIDIME, LEVOFLOXACIN, MOXIFLOXACIN, LINEZOLID, CEFAZOLIN, TEICOPLANIN, AMPICILLIN, AMOXICILLIN SODIUM, CEFAZOLIN, MOXIFLOXACIN, LEVOFLOXACIN, Septrin Forte 160 mg/800 mg Tablets

Primary endpoint: Due to clinical failure in OCD evaluation: - Non-disappearance or return to baseline of all initial clinical criteria. - Non-disappearance of symptoms and signs of infection. - Appearance of new infection symptoms. - Need to suspend antibiotic or add another due to lack of effectiveness. - In debridement is performed with retention: intraoperative and BM sonication cultures when removing BM when the fracture consolidates. - Use of the REBORNE fracture consolidation scale.
Endpoint(s): Clinical variable: -Efficacy of each group of antibiotics -Development of secondary infections -Recurrence rate (recurrences and reinfections) -Need for new surgeries (debridement, removal of material, coverage, amputation). -Evaluation of different reconstruction strategies (bone and soft tissue) carried out in order to recover lost functionality. -Functional status (defined as the recovery of the functionality of the extremity prior to the fracture) and quality of life., Microbiological variable: -Development of resistance during treatment. -C. difficile infection during or 30 days after treatment, Adverse effects and complications: Occurrence of adverse events (frequency and severity), including death (ie, all-cause mortality)., Consumption of health resources: The consumption of health resources will be evaluated for each treatment group: days of antibiotic treatment, hospital stay, readmissions, number of surgeries performed.

Source: https://euclinicaltrials.eu/ctis-public/view/2023-508442-18-00